EU clinical trial 2024-516234-35-00: A Phase 1b/2, Open-Label, Master Protocol Study of BTK-Degrader BGB-16673 in Combination With Other Agents in Patients With Relapsed or Refractory B-Cell Malignancies
Protocol code: BGB-16673-104
Sponsor: BeOne Medicines AG (Pharmaceutical company). Phase: Phase I and Phase II (Integrated)- Other. Countries: Italy (ongoing, recruiting), Germany (ongoing, recruiting), Poland (ongoing, recruiting).
Therapeutic area(s): Diseases [C] - Neoplasms [C04]
Gender: Female, Male. Age: 18-64 years, 65+ years. Enrolment: 99.
Status: Ongoing, recruiting. Start date (EU): 2025-10-15. Decision date: 2025-09-23. Results received: No. Last updated: 2026-06-10.
Decision dates by country: DE: 2025-09-23, IT: 2025-09-24, PL: 2025-11-03

Condition(s): Relapsed or Refractory B-Cell Malignancies
Product: BGB-16673, Gazyvaro 1,000 mg concentrate for solution for infusion., Columvi 10 mg concentrate for solution for infusion, Gazyvaro 1,000 mg concentrate for solution for infusion., BGB-11417, Mosunetuzumab, Gazyvaro 1,000 mg concentrate for solution for infusion., BGB-11417, BGB-16673, Mosunetuzumab, Columvi 10 mg concentrate for solution for infusion, Gazyvaro 1,000 mg concentrate for solution for infusion., Zanubrutinib, Columvi 10 mg concentrate for solution for infusion, BGB-11417, BGB-11417, Columvi 10 mg concentrate for solution for infusion

Primary endpoint: Number of patients with dose-limiting toxicities (Part 1a), Number of patients with treatment-emergent adverse events (Part 1a, part 1b), Number of patients with treatment-related adverse events (Part 1a, part 1b), Number of patients with serious adverse events (Part 1a, part 1b)
Endpoint(s): Overall response rate (ORR) as assessed by the investigator (Part 1a, part 1b), Duration of response (DOR) (Part 1a, part 1b), Time-to-response (TTR) (Part 1a, part 1b), Derived PK parameters of BGB-16673 (Part 1a), Plasma concentration data (Part 1a, part 1b), Number of patients with complete response/complete response with incomplete count recovery (CR/CRi) who achieve uMRD status with < 10^(-4) sensitivity in peripheral blood and/or bone marrow (Part 1b, sub-study 1 only), Derived PK parameters of sonrotoclax (Part 1a, sub-study 1 only)

Source: https://euclinicaltrials.eu/ctis-public/view/2024-516234-35-00